EU clinical trial 2023-504899-25-00: MK-5684-003: A Phase 3 Randomized, Open-label Study of MK-5684 Versus Alternative Abiraterone Acetate or Enzalutamide in Participants With Metastatic Castration-resistant Prostate Cancer (mCRPC) Previously Treated With Next-generation Hormonal Agent (NHA) and Taxane-based Chemotherapy (OMAHA-003)
Protocol code: MK-5684-003
Sponsor: Merck Sharp & Dohme LLC (Pharmaceutical company). Phase: Therapeutic confirmatory (Phase III). Countries: Finland (ongoing, recruiting), Austria (ongoing, recruiting), Spain (ongoing, recruiting), Poland (ongoing, recruiting), Italy (ongoing, recruiting), Czechia (ongoing, recruiting), Sweden (ongoing, recruiting), Norway (ongoing, recruiting), France (ongoing, recruiting), Hungary (ongoing, recruiting), Germany (ongoing, recruiting), Ireland (ongoing, recruiting), Netherlands (ongoing, recruiting), Denmark (ongoing, recruiting).
Therapeutic area(s): Diseases [C] - Neoplasms [C04]
Gender: Male. Age: 18-64 years, 65+ years. Enrolment: 393.
Status: Ongoing, recruiting. Start date (EU): 2024-04-04. Decision date: 2024-03-18. Results received: No. Last updated: 2026-02-16.
Decision dates by country: CZ: 2024-03-18, DE: 2024-03-20, SE: 2024-03-21, FI: 2024-03-18, IE: 2024-03-22, ES: 2024-03-18, NO: 2024-05-06, PL: 2024-03-25, NL: 2024-03-25, IT: 2024-03-19, AT: 2024-03-25, DK: 2024-03-18, HU: 2024-03-19, FR: 2024-03-21

Condition(s): Metastatic castration resistant prostate cancer
Product: HYDROCORTISONE, PREDNISONE ACETATE, ENZALUTAMIDE, DEXAMETHASONE ACETATE, PREDNISONE, Opevesostat, ABIRATERONE ACETATE, DEXAMETHASONE, HYDROCORTISONE, HYDROCORTISONE, FLUDROCORTISONE, ABIRATERONE ACETATE, PREDNISOLONE, HYDROCORTISONE, FLUDROCORTISONE ACETATE

Primary endpoint: Overall Survival (OS) in Androgen Receptor Ligand Binding Domain (AR LBD) mutation-positive participants, OS in AR LBD mutation-negative participants
Endpoint(s): Radiographic Progression-free Survival (rPFS) Per Prostate Cancer Working Group-modified Response Evaluation Criteria in Solid Tumors Version 1.1 (RECIST 1.1) as Assessed by Blinded Independent Central Review in AR LBD mutation-positive participants, rPFS Per Prostate Cancer Working Group-modified RECIST 1.1 as Assessed by Blinded Independent Central Review in AR LBD mutation-negative participants, Time to Initiation of the First Subsequent Anti-Cancer Therapy or Death (TFST), Objective Response (OR) Per Prostate Cancer Working Group (PCWG)-modified Response Evaluation Criteria in Solid Tumors Version 1.1 (RECIST 1.1) as Assessed by Blinded Independent Central Review, Duration of Response (DOR) Per PCWG-modified RECIST 1.1 as Assessed by Blinded Independent Central Review, Time to Pain Progression (TTPP) as Assessed by Brief Pain Inventory-Short Form (BPI-SF) Item 3 ("Worst Pain in 24 Hours") and Opiate Analgesic Use (Analgesic Quantification Algorithm [AQA] Score), Time to Prostate-specific Antigen (PSA) Progression, Time to First Symptomatic Skeletal-related Event (SSRE), Number of Participants Who Experience an Adverse Event, Number of Participants Who Discontinue Study Treatment Due to an Adverse Event

Source: https://euclinicaltrials.eu/ctis-public/view/2023-504899-25-00